EU clinical trial 2024-519262-42-00: A Randomized phase II trial of Cemiplimab plus OSE2101 (TEDOPI®) as maintenance therapy in ctDNA positive NSCL. The Cemited study.
Sponsor: Fondazione Ricerca Traslazionale (Laboratory/Research/Testing facility). Phase: Therapeutic exploratory (Phase II). Countries: Italy (ongoing, recruiting).
Therapeutic area(s): Diseases [C] - Neoplasms [C04]
Gender: Female, Male. Age: 18-64 years, 65+ years. Enrolment: 90.
Status: Ongoing, recruiting. Start date (EU): 2025-07-15. Decision date: 2025-04-17. Results received: No. Last updated: 2026-02-24.

Condition(s): NSCLC non-small cell lung cancer
Product: TEDOPI, LIBTAYO 350 mg concentrate for solution for infusion., Armisarte 25 mg/ml concentrate for solution for infusion

Primary endpoint: Differences in ctDNA clearance rate in the two arms of treatment
Endpoint(s): - Overall Survival - Progression Free Survival according to RECSIT 1:1 - Overall Response Rate (ORR) according to RECSIT 1:1 --- Incidence of any grade Adverse Events measured according to NCI-CTCAE (v. 5.0) Levels of other biomarkers (including PD-L1 and TMB) during the treatments and statistical associations with other outcome measures

Source: https://euclinicaltrials.eu/ctis-public/view/2024-519262-42-00